EU clinical trial 2024-513957-55-00: A multi-center Phase 2 study of neoadjuvant immunotherapy in combination with the anti-GDF-15 antibody visugromab (CTL-002) for the treatment of muscle invasive bladder cancer
Protocol code: CTL-002-002
Sponsor: CatalYm GmbH (Pharmaceutical company). Phase: Therapeutic exploratory (Phase II). Countries: Italy (ended).
Therapeutic area(s): Diseases [C] - Neoplasms [C04]
Gender: Female, Male. Age: 18-64 years, 65+ years. Enrolment: 31.
Status: Ended. Start date (EU): 2023-07-21. End date (EU): 2026-06-05. Decision date: 2024-07-30. Results received: No. Last updated: 2026-04-30.

Condition(s): Muscle invasive bladder cancer set to undergo radical cystectomy who cannot receive or refuse to receive cisplatin-based chemotherapy
Product: SODIO CLORURO BAXTER S.P.A. 0,9% Soluzione per infusione, OPDIVO 10 mg/mL concentrate for solution for infusion., OPDIVO 10 mg/mL concentrate for solution for infusion., OPDIVO 10 mg/mL concentrate for solution for infusion., OPDIVO 10 mg/mL concentrate for solution for infusion., Visugromab (CTL-002)

Primary endpoint: Pathological complete response (pCR) rate of visugromab (CTL-002) in combination with an anti-PD-1 checkpoint inhibitor or an anti-PD-1 checkpoint inhibitor alone, as determined by local pathologist review, Radiological response rate according to Response Evaluation Criteria in Solid Tumors (RECIST) v1.1 of visugromab (CTL-002) in combination with an anti-PD-1 checkpoint inhibitor or an anti-PD-1 checkpoint inhibitor alone, as assessed by the Investigator
Endpoint(s): Evaluation of the number of participants with adverse events (AEs) including serious adverse events (SAEs), (related or unrelated to IMPs), abnormal clinical laboratory data, and physical findings of visugromab (CTL-002) in combination with an anti-PD-1 checkpoint inhibitor or an anti-PD-1 checkpoint inhibitor alone, Evaluation of number of participants with treatment-related delay of surgery, Evaluation of PK parameters of visugromab (CTL-002; e.g., maximum concentration [Cmax], area under the curve [AUC], and half-life [t1/2]), Evaluation of GDF-15 baseline serum levels and their correlation with pharmacodynamics and clinical activity, Evaluation of visugromab-induced anti-drug antibodies (ADA) development., Pathological complete response (pCR) rate of visugromab (CTL-002) in combination with an anti-PD-1 checkpoint inhibitor or an anti-PD-1 checkpoint inhibitor alone, as determined by central independent pathologist review, Radiological response rate according to Response Evaluation Criteria in Solid Tumors (RECIST) v1.1 of visugromab (CTL-002) in combination with an anti-PD-1 checkpoint inhibitor or an anti-PD-1 checkpoint inhibitor alone, as assessed by central independent review, Major pathological response (MPR) rate defined as residual ypT0/1/a/isN0M0 (including pathological complete responses) of visugromab (CTL-002) in combination with an anti-PD-1 checkpoint inhibitor or an anti-PD-1 checkpoint inhibitor alone, as determined by local pathologist review or central independent pathologist review, Evaluation of event-free survival (EFS), time to relapse (TTR), and overall survival (OS), Positron emission tomography (PET)-computed tomography (CT) and/or multiparametric (mp) magnetic resonance imaging (MRI) assessed response of visugromab (CTL-002) in combination with an anti-PD-1 checkpoint inhibitor or an anti-PD-1 checkpoint inhibitor alone, if available

Source: https://euclinicaltrials.eu/ctis-public/view/2024-513957-55-00